EU clinical trial 2023-509774-40-00: A Phase 3 Study of Pembrolizumab in Combination with Pemetrexed/Platinum (Carboplatin or Cisplatin) Followed by Pembrolizumab and Maintenance Olaparib vs Maintenance Pemetrexed in the First-Line Treatment of Participants with Metastatic Nonsquamous Non-Small-Cell Lung Cancer (NSCLC)
Protocol code: MK-7339-006
Sponsor: Merck Sharp & Dohme LLC (Pharmaceutical company). Phase: Therapeutic confirmatory (Phase III). Countries: Romania (ended), Austria (ended), Germany (ended), Spain (ended), France (ended), Poland (ended).
Therapeutic area(s): Diseases [C] - Neoplasms [C04]
Gender: Female, Male. Age: 18-64 years, 65+ years. Enrolment: 185.
Status: Ended. Start date (EU): 2019-06-25. End date (EU): 2026-01-25. End date: 2026-01-30. Decision date: 2024-04-26. Results received: No. Last updated: 2026-01-26.
Decision dates by country: DE: 2024-04-29, ES: 2024-04-29, RO: 2024-04-30, PL: 2024-04-29, AT: 2024-04-26, FR: 2024-04-29

Condition(s): Stage IV lung cancer condition
Product: Olaparib, CISPLATIN, Olaparib, KEYTRUDA 25 mg/mL concentrate for solution for infusion, PEMETREXED, CARBOPLATIN

Primary endpoint: Progression-free Survival (PFS) Per Response Evaluation Criteria in Solid Tumors Version 1.1(RECIST 1.1), Overall Survival (OS)
Endpoint(s): Number of Participants Experiencing an Adverse Event (AE), Number of Participants Discontinuing Study Treatment Due to Adverse Event (AE), Change from Baseline in European Organization for Research and Treatment of Cancer (EORTC)Quality of Life Questionnaire-Core 30 (QLQ-C30) GlobalHealth Status /Quality of Life(Items 29 and30) Scale Score, Change from Baseline in EORTC Quality of Life Questionnaire Lung Cancer Module 13 (QLQ-LC13) Cough (Item 1) Scale Score, Change from Baseline in EORTC QLQ-LC13 Chest Pain (Item 10) Scale Score, Change from Baseline in EORTC QLQ-C30 Dyspnea (Item 8) Scale Score, Change from Baseline in EORTC QLQ-C30 Physical Functioning (Items 1 to 5) Scale Score, Time to True Deterioration (TTD) in EORTC QLQ-C30 Global Health Status/Quality of Life (Items 29 & 30) Scale Score, Time to True Deterioration (TTD) in EORTC Quality of Life Questionnaire Lung Cancer Module 13 (QLQ-LC13) Cough (Item 1) Scale Score, Time to True Deterioration (TTD) in EORTC QLQ-LC13 Chest Pain (Item 10) Scale Score, Time to True Deterioration (TTD) in EORTC QLQ-C30 Dyspnea (Item8) Scale Score, Time to True Deterioration (TTD) in EORTC QLQ-C30 Physical Functioning (Items 1 to 5) Scale Score

Source: https://euclinicaltrials.eu/ctis-public/view/2023-509774-40-00